EU clinical trial 2024-511999-32-00: A Phase 1/2a Open Label, Multicenter Study to Assess the Safety, Tolerability, Pharmacokinetics, and Efficacy of AFM24 in Combination with Atezolizumab in Patients with Selected Advanced/Metastatic EGFR-expressing Cancers
Protocol code: AFM24-102
Sponsor: Affimed GmbH (Pharmaceutical company). Phase: Phase I and Phase II (Integrated)- Other. Countries: Poland (ended), Spain (ended).
Therapeutic area(s): Diseases [C] - Neoplasms [C04]
Gender: Female, Male. Age: 18-64 years, 65+ years. Enrolment: 127.
Status: Ended. Start date (EU): 2021-11-19. End date (EU): 2025-06-11. Decision date: 2024-04-17. Results received: Yes. Last updated: 2025-03-06.
Decision dates by country: PL: 2024-05-16, ES: 2024-04-17

Condition(s): Advanced/Metastatic EGFR-expressing Cancers
Product: RAMUCIRUMAB, AFM24, AFM24, ATEZOLIZUMAB, DOCETAXEL, DOCETAXEL, ATEZOLIZUMAB

Primary endpoint: Dose Escalation Phase (Phase 1): -AEs to be assessed by the incidence and severity of DLT within the DLT observation period (Cycle 1) Phase 2a -ORR according to RECIST v1.1 determined by Investigator assessment
Endpoint(s): 1. Dose Escalation Phase (Phase 1): - Incidence of patients with TEAEs and SAEs - ORR using RECIST v1.1 determined by Investigator assessment - PK parameters of AFM24: Cmax, Tmax, Cmin and AUCtau - Frequency of patients developing ADAs against AFM24, 2.1 Phase 2a: - PFS according to RECIST v1.1 by Investigator assessment - DOR according to RECIST v1.1 by Investigator assessment - CBR according to RECIST v1.1 by Investigator assessment, 2.2 Phase 2a: - DCR according to RECIST v1.1 by Investigator assessment - Incidence of patients with TEAEs and SAEs - PK parameters of AFM24: Cmax, Tmax, Cmin, and AUCtau - Frequency of patients developing ADAs against AFM24

Source: https://euclinicaltrials.eu/ctis-public/view/2024-511999-32-00